EU clinical trial 2025-524229-41-00: PembroLizumab Adjuvant in patients with early-stage Triple NEgaTive breast cancer with residual disease after neoadjuvant pembrolizumab plus chemotherapy – the multicenter, randomized phase III, pragmatic PLANET trial
Sponsor: Het Nederlands Kanker Instituut-Antoni van Leeuwenhoek Ziekenhuis Stichting (Hospital/Clinic/Other health care facility). Phase: Therapeutic confirmatory (Phase III). Countries: Netherlands (ongoing, recruiting).
Therapeutic area(s): Diseases [C] - Neoplasms [C04]
Gender: Female, Male. Age: 18-64 years, 65+ years. Enrolment: 1000.
Status: Ongoing, recruiting. Start date (EU): 2026-07-08. Decision date: 2026-04-01. Results received: No. Last updated: 2026-07-16.

Condition(s): Triple negative breast cancer
Product: Teysuno 15 mg/4.35 mg/11.8 mg hard capsules, Lynparza 150 mg film-coated tablets, Capecitabine Accord 500 mg film-coated tablets, KEYTRUDA 25 mg/mL concentrate for solution for infusion., Capecitabine Accord 150 mg film-coated tablets

Primary endpoint: Invasive disease-free survival (IDFS)
Endpoint(s): Distant disease-free survival (DDFS), Overall survival (OS), Safety/adverse events, Global health/QoL and physical functioning (assessed via EQ-5D, EORTC QLQ C30 and EORTC QLQ-BR42), Cost-effectiveness, IDFS, DDFS and OS in the PLANET registry

Source: https://euclinicaltrials.eu/ctis-public/view/2025-524229-41-00